EU clinical trial 2025-523994-41-00: A Phase III, Randomized, Double-blind, Parallel-group, Placebo-controlled Multicenter Study to Evaluate the Effect of Elecoglipron in Reducing Renal Outcomes and Mortality in Participants with Chronic Kidney Disease (Elevate-CKD)
Protocol code: D7265C00001
Sponsor: AstraZeneca AB (Pharmaceutical company). Phase: Therapeutic confirmatory (Phase III). Countries: Czechia (authorised, recruitment pending), Italy (authorised, recruitment pending), Hungary (authorised, recruitment pending), Bulgaria (authorised, recruitment pending), Sweden (authorised, recruitment pending), Denmark (authorised, recruitment pending), Spain (authorised, recruitment pending), Norway (authorised, recruitment pending), Finland (authorised, recruitment pending), Greece (authorised, recruitment pending), France (authorised, recruitment pending), Germany (authorised, recruitment pending).
Therapeutic area(s): Diseases [C] - Cardiovascular Diseases [C14]
Gender: Female, Male. Age: 18-64 years, 65+ years. Enrolment: 1360.
Status: Authorised, recruitment pending. Decision date: 2026-07-24. Results received: No. Last updated: 2026-08-05.
Decision dates by country: BG: 2026-07-31, CZ: 2026-07-24, DK: 2026-08-03, FI: 2026-08-04, FR: 2026-07-28, DE: 2026-07-29, GR: 2026-07-27, HU: 2026-08-05, IT: 2026-07-29, ES: 2026-08-05, SE: 2026-07-24, NO: 2026-07-24

Condition(s): Chronic kidney disease (CKD) in adults, with specified ranges of eGFR and albuminuria (UACR), irrespective of T2DM status; background SGLT2i dapagliflozin 10 mg as GDMT.
Product: Elecoglipron, Elecoglipron, Elecoglipron, Forxiga 10 mg film-coated tablets, Placebo for Elecoglipron (AZD5004), Elecoglipron

Primary endpoint: Time to first occurrence of any component of the composite of: ≥50% sustained decline in eGFR, end-stage kidney disease (ESKD; sustained eGFR <10 mL/min/1.73 m2, chronic dialysis, or renal transplant), or all-cause mortality.
Endpoint(s): Time to first occurrence of composite of ≥50% sustained decline in eGFR, ESKD, or CV and renal death., Time to composite of all-cause mortality, MI, or stroke., Time to 3-point MACE (CV death, MI, stroke)., Time to all-cause mortality., Time to CV death., Time to first occurrence of any component of pure renal composite: ≥50% sustained decline in eGFR, ESKD, or renal death., Time to composite of CV death or hospitalization for HF (hHF)., Time to composite of CV death MI, stroke, or HF hospitalizations., Time to all-cause hospitalization.

Source: https://euclinicaltrials.eu/ctis-public/view/2025-523994-41-00